EU clinical trial 2025-522034-31-00: Open-label single dose trial to evaluate pharmacokinetics, safety, and acceptability/palatability of oveporexton in children from 6 years to less than 18 years of age with narcolepsy type 1 (NT1)
Protocol code: TAK-861-1012
Sponsor: Takeda Development Center Americas Inc. (Pharmaceutical company). Phase: Human Pharmacology (Phase I)- Other. Countries: Italy (ended).
Therapeutic area(s): Diseases [C] - Nervous System Diseases [C10]
Gender: Female, Male. Age: 0-17 years. Enrolment: 16.
Status: Ended. Start date (EU): 2026-01-07. End date (EU): 2026-05-21. End date: 2026-05-22. Decision date: 2025-11-27. Results received: No. Last updated: 2025-11-27.

Condition(s): Narcolepsy with Cataplexy (Narcolepsy Type 1)
Product: TAK-861, TAK-861, TAK-861

Primary endpoint: Maximum observed concentration (Cmax). Time to reach maximum observed concentration (tmax). Area under the concentration-time curve from time 0 to infinity (AUC∞), calculated using the observed value of the last quantifiable concentration.
Endpoint(s): Occurrence of at least 1 TEAE., Participants rating acceptability and palatability.

Source: https://euclinicaltrials.eu/ctis-public/view/2025-522034-31-00